EU clinical trial 2025-521127-73-00: A Phase 3, Non-Inferiority, Randomized, Open-Label, Parallel Group, Multicenter Study To Evaluate The Pharmacokinetics, Pharmacodynamics, Safety, Radiological and Clinical Effects Of Subcutaneous Ublituximab Versus Intravenous Ublituximab In Patients With Multiple Sclerosis
Protocol code: TG1101-RMS-SC301
Sponsor: Tg Therapeutics Inc. (Pharmaceutical company). Phase: Therapeutic confirmatory (Phase III). Countries: Croatia (ongoing, recruitment ended), Bulgaria (ongoing, recruitment ended), Czechia (ongoing, recruitment ended), Hungary (ongoing, recruitment ended).
Therapeutic area(s): Diseases [C] - Nervous System Diseases [C10]
Gender: Female, Male. Age: 18-64 years. Enrolment: 84.
Status: Ongoing, recruitment ended. Start date (EU): 2025-09-12. Decision date: 2025-08-19. Results received: No. Last updated: 2026-07-20.
Decision dates by country: CZ: 2025-08-19, HR: 2025-08-20, HU: 2025-08-21, BG: 2025-08-19

Condition(s): Relapsing forms of Multiple Sclerosis
Product: ublituximab, Ublituximab

Primary endpoint: Commercially confidential information
Endpoint(s): Proportion of participants with CD19+ B- cell (please ref to the protocol for the full information), Incidence of treatment emergent adverse events (TEAE)

Source: https://euclinicaltrials.eu/ctis-public/view/2025-521127-73-00